EU clinical trial 2025-522490-11-00: T cell imaging in kidney transplantation (TIK)
Protocol code: R0043300
Sponsor: Radboud universitair medisch centrum Stichting (Hospital/Clinic/Other health care facility). Phase: Human Pharmacology (Phase I)- Other. Countries: Netherlands (authorised, recruitment pending).
Therapeutic area(s): Analytical, Diagnostic and Therapeutic Techniques and Equipment [E] - Diagnosis [E01]; Phenomena and Processes [G] - Immune system processes [G12]
Gender: Female, Male. Age: 18-64 years, 65+ years. Enrolment: 9.
Status: Authorised, recruitment pending. Decision date: 2026-06-04. Results received: No. Last updated: 2026-06-04.

Condition(s): Renal allograft rejection
Product: Zr89

Primary endpoint: The [89Zr]-Df-Crefmirlimab PET signal in kidneys (native/graft), lymph nodes (cervical, hilair, mediastinal), spleen, liver and bone marrow in patients with and without rejection or T cell depleting therapy.
Endpoint(s): In addition to the [89Zr]Df-Crefmirlimab PET/CT, we will also quantify various immune cell subsets, such as CD8+ T cells, in blood by flow cytometry.

Source: https://euclinicaltrials.eu/ctis-public/view/2025-522490-11-00